EU clinical trial 2024-516918-37-00: Quality of life and neurocognitive functioning in diffuse low-grade glioma patients treated with Temozolomide: feasibility study - TEMOIN
Protocol code: ICM-URC 2016/32
Sponsor: Institut Regional Du Cancer De Montpellier (Hospital/Clinic/Other health care facility). Phase: Therapeutic exploratory (Phase II). Countries: France (authorised, recruitment pending).
Therapeutic area(s): Diseases [C] - Neoplasms [C04]
Gender: Female, Male. Age: 18-64 years, 65+ years. Enrolment: 24.
Status: Authorised, recruitment pending. Decision date: 2024-09-19. Results received: No. Last updated: 2024-09-19.

Condition(s): Diffuse low-grade gliomas
Product: TEMOZOLOMIDE

Primary endpoint: Feasability will be analyzed using two parameters: 1.participation rate: proportion of patients that consent to participate in the study among the screened patients. We expect that 80% of the sceened patients will consent to the study. 2. compliance rate: the proportion of included patients that will complete the evaluations at baseline, 6 months and 12 months. We expect that 80% of patients will be compliant.
Endpoint(s): The total score obtained at the EORTC QLQ-C30 and the scores obtained at the different dimensions of the QLQ-C30 (ranged from 0 to 100) according to the EORTC’s instructions;, The total score obtained at the QLQ-BN20 and the scores obtained at the different dimensions of the QLQ-BN20 (ranged from 0 to 100) according to the EORTC’s instructions, Le score total obtenu au questionnaire IMF (Inventaire Multifactoriel de Fatigue), The four scores obtained at the four subscales of the french FACT-Cog (Functional Assessment of Cancer Therapy-Cognitive Function) assessing the perceived cognitive impairments (from 0 to 72), the comments from others (from 0 to 16), the perceived cognitive abilities (from 0 to 16), and the impact on quality of life (from 0 to 28);, The percentage of patients experiencing a decline in the QoL scores: decline is defined as ≥ 20% of decrease with the following calcul: [(score at baseline – score at further evaluation)/score at baseline]*100., The total score (from 0 to 50) obtained at the f-NART (French version of the National Adult Reading Test) according to the Mackinnon and Mulligan (2005)’s instructions;, The total score (from 0 to 30) obtained at the MoCA (Montreal Cognitive Assessment) according to the Nasreddine et al. (2012)’s instructions;, The index of psychomotor speed (ranged from 40 to 160) according to the Wechsler (2011)’s calculation rules, which are based on the scores obtained at the Digit-symbol substitution test and the Code test of the WAIS-IV., The scores obtained at the HVLT-R (Revised Hopkins Verbal Learning Test) according to Rieu et al (2006)’s instructions: the number of correct free recalls (for each of the 3 trials), the total learned score, the number of correct delayed recalls, the recognition hits rate, the false positives rate, the discrimination rate, the number of intrusions and perseverations;, The four scores obtained at the complex Rey figure, as noticed in the instructions of Wallon and Mesmin (2009) (copy type, , timing, free immediate and delayed and recall);, The different scores obtained at the MemProsp tasks (both event and time-based tasks) according to Einstein and Mc Daniel (1990)’s instructions: number of correct prospective memory responses, number of calls for the time counter (over the entire session and within the last 30-second before the target), number of correct word ratings., The timing (ms), the number and type of errors (flexibility, proximity or attentionnal) gathered at the TMT A and B (Trail Making Test A and B) as Ashendorf et al. (2008) and Godefroy et al. (2010) described in their instructions;, The timing (ms), the total number of omissions (from 0 to 35), and the difference between left omissions and right omissions gathered at the Bell’s test, according to the Rousseaux et al. (2001)’s instructions;, The number and percentage of patients who report high-grade (grade 3-4-5 according to the CTCAE-NCI criteria) adverse reactions of interest will be summarized for all treated patients;, The Objective Response Rate (ORR), defined as the number and percentage of patients with a best overall response of complete response (CR) or partial response (PR) recorded between the date of first dose of TMZ and the date of the objectively documented tumor progression according to the RANO criteria (van den Bent et al., 2011) in all treated patients, The proportion of patients experiencing a decrease of their tumor volume under TMZ. The tumor volume (cm3), determined on the T2/FLAIR sequence of the brain MRI (in DICOM format) using manual delineation of the tumor limits on each slide and calculation of the volume on a dedicated software;, The PFS, defined as the delay between the date of introduction of TMZ and the date of the progression (according to the RANO criteria) or death from any cause;, The OS, defined as the delay between the date of introduction of TMZ and death from any cause.

Source: https://euclinicaltrials.eu/ctis-public/view/2024-516918-37-00